EU clinical trial 2023-507575-22-00: Imaging Perfusion Restrictions from Extracellular Solid Stress - An open-label losartan study (ImPRESS)
Sponsor: Oslo University Hospital HF (Hospital/Clinic/Other health care facility). Phase: Therapeutic exploratory (Phase II). Countries: Norway (ongoing, recruitment ended).
Therapeutic area(s): Diseases [C] - Neoplasms [C04]
Gender: Female, Male. Age: 18-64 years, 65+ years. Enrolment: 153.
Status: Ongoing, recruitment ended. Start date (EU): 2019-09-25. Decision date: 2024-09-26. Results received: No. Last updated: 2026-01-15.

Condition(s): Glioblastoma - newly diagnosed and recurrent tumors (Study A), Brain metastases from non-small-cell lung cancer (NSCLC) (Study B)
Product: Cozaar 50 mg tablett, filmdrasjert, Cozaar 100 mg tablett, filmdrasjert, Cozaar 12,5 mg tablett, filmdrasjert

Primary endpoint: Change from baseline in the radiographic biomarker relative cerebral blood flow (rCBF) in the primary tumor area, and normalized to reference tissue [Time Frame: Study A (patients with recurrent glioblastoma) Baseline, Day 14-16, Day 28-30, Day 42-44.Study A (patients with newly diagnosed glioblastoma) Baseline, Day 14-16, Day 28-30, Day 42-44.tudy B (lung patients with metastases to the brain) Baseline, Day 90-14, Day 180-14, Day 270-14], Change from baseline in the radiographic biomarker tissue stiffness, as derived from the shear wave modulus G of the MR-elastography readout in the primary tumor area, and normalized to reference tissue [Time Frame: Study A (patients with recurrent and newly diagnosed glioblastoma) Baseline, Day 14-16, Day 28-30, Day 42-44.Study B (lung patients with metastases to the brain) Baseline, Day 90-14, Day 180-14, Day 270-14]
Endpoint(s): Change from baseline in experimental radiographic biomarkers from MRI, including total volume of enhancing tumor, the total volume of tumor edema, perfusion MRI, diffusion MRI, or MR Elastography., and normalized to reference tissue., Change from baseline in neurologic performance scores by Karnofsky Performance Score (KPS), Eastern Cooperative Oncology Group (ECOG) and/or Neurologic Assessment in Neuro- Oncology (NANO) scores., Best overall response of radiographic status on MRIs of intracranial disease or corresponding treatment response by the Response Assessment in Neuro-Oncology (RANO) criteria. (occurrence of radionecrosis, pseudoprogression or tumor progression)., Total dose and change in steroids dosage during study treatment duration., Change from baseline in the European Organization for Research and Treatment of Cancer (EORTC) quality of life questionnaire (QLQ BN20) core 30 version 3.0., Six-months progression free survival (6MPFS), Progression free survival (PFS) [Time Frame: up to 24 months], Overall survival (OS) at 12 and 24 months, Overall survival [Time Frame: up to 24 months], Drug tolerance of IMP (NCI-CTCAE v4.0) according to study and follow-up period, including number and frequency of losartan treatment emerging adverse events (TEAE), vital signs (, blood pressure, pulse) and conventional laboratory blood parameters., Change from baseline in experimental biomarkers from blood and serum, including vascular endothelial growth factors, angiopoietins, placental growth factors, epidermal growth factor receptors, hyaluronan levels, collagens levels, and inflammatory cytokines.

Source: https://euclinicaltrials.eu/ctis-public/view/2023-507575-22-00